EU clinical trial 2024-510946-15-00: ORACLE: A long-term follow-up study to evaluate the safety of GT005 in participants with geographic atrophy, secondary to age-related macular degeneration treated in a Gyroscope-sponsored antecedent study.
Protocol code: CPPY988A12203B
Sponsor: Novartis Pharma AG (Pharmaceutical company). Phase: Phase I and Phase II (Integrated)- Other. Countries: Spain (ongoing, recruitment ended), Poland (ongoing, recruitment ended), Germany (ongoing, recruitment ended), France (ongoing, recruitment ended).
Therapeutic area(s): Diseases [C] - Eye Diseases [C11]
Gender: Female, Male. Age: 18-64 years, 65+ years. Enrolment: 30.
Status: Ongoing, recruitment ended. Start date (EU): 2022-12-08. Decision date: 2024-04-29. Results received: No. Last updated: 2026-07-24.
Decision dates by country: ES: 2024-04-29, PL: 2024-05-06, FR: 2024-05-06, DE: 2024-05-08

Condition(s): Geographic atrophy (GA) secondary to age-related macular degeneration (AMD) in participants already treated with GT005 in the previous studies GT005-01 (FOCUS), GT005-02 (EXPLORE) and GT005-03 (HORIZON).
Product: PPY988A

Primary endpoint: Incidence and severity of ocular and systemic Adverse Events

Source: https://euclinicaltrials.eu/ctis-public/view/2024-510946-15-00